EU clinical trial 2023-510566-27-00: MOST Plus (My Own Specific Treatment) - A two-period, multicenter, randomized, open-label, phase II study evaluating the clinical benefit of a maintenance treatment targeting tumor molecular alterations in patients with progressive locally-advanced or metastatic solid tumors
Protocol code: ET-12-081
Sponsor: Centre Leon Berard (Hospital/Clinic/Other health care facility). Phase: Therapeutic exploratory (Phase II). Countries: France (ongoing, recruiting).
Therapeutic area(s): Diseases [C] - Neoplasms [C04]
Gender: Female, Male. Age: 18-64 years, 65+ years. Enrolment: 900.
Status: Ongoing, recruiting. Start date (EU): 2014-02-27. Decision date: 2024-10-01. Results received: No. Last updated: 2026-07-21.

Condition(s): Advanced / Metastatic cancers
Product: IMJUDO 20 mg/ml concentrate for solution for infusion., Tasigna 200 mg hard capsules, Lynparza 150 mg film-coated tablets, Lynparza 100 mg film-coated tablets, IMFINZI 50 mg/mL concentrate for solution for infusion.

Primary endpoint: Induction period: The 12-week Progression-Free Rate (PFR) or 52-week PFR for IT, Maintenance period Progression-Free Survival (PFS)
Endpoint(s): - Induction period The Objective Response Rate (ORR), - Maintenance period Secondary endpoints of the maintenance period will be analyzed on the ITT population. Overall survival (OS) and EORTC QLQ-C30 scores, - Whole study period Progression-Free Survival, - Whole study period: The duration of response, - Whole study period: Safety assessment

Source: https://euclinicaltrials.eu/ctis-public/view/2023-510566-27-00